EU clinical trial 2024-515876-10-00: A study to investigate the similarity of two different Tiotropium inhalers in healthy volunteers.
Protocol code: CSH19003
Sponsor: invoX Belgium, CCDRD Cooperative Clinical Drug Research and Development AG (Pharmaceutical company). Phase: Human Pharmacology (Phase I)- Bioequivalence Study. Countries: Bulgaria (ended).
Therapeutic area(s): Diseases [C] - Respiratory Tract Diseases [C08]
Gender: Female, Male. Age: 18-64 years. Enrolment: 40.
Status: Ended. End date (EU): 2025-11-26. Decision date: 2024-11-28. Results received: No. Last updated: 2024-11-28.

Condition(s): No therapeutic indication in the present bioequivalence trial with healthy volunteers

Source: https://euclinicaltrials.eu/ctis-public/view/2024-515876-10-00